EU clinical trial 2025-524976-40-00: ECSIP : Early Corticosteroids in Severe Influenza Pneumonia, a phase III randomized controlled trial
Protocol code: 2025-02-CHRMT
Sponsor: Centre Hospital Region Metz Thionville (Hospital/Clinic/Other health care facility). Phase: Therapeutic confirmatory (Phase III). Countries: France (authorised, recruitment pending).
Therapeutic area(s): Diseases [C] - Respiratory Tract Diseases [C08]
Gender: Female, Male. Age: 18-64 years, 65+ years. Enrolment: 544.
Status: Authorised, recruitment pending. Decision date: 2026-06-23. Results received: No. Last updated: 2026-06-23.

Condition(s): patients with influenza-induced acute hypoxemic respiratory failure
Product: DEXAMETHASONE VIATRIS 20 mg/5 ml, solution injectable en ampoule, CHLORURE DE SODIUM 0,9 % LAVOISIER, solution pour perfusion

Primary endpoint: Hierarchical composite endpoint, scored as follows: 1. In-hospital death (all-cause) at day 28 (yes/no), 2. If alive at day 28, number of ventilator-free days between day 0 and day 28, 3. If mechanical ventilation never required, number of ICU-free days between day 0 and day 28. Each patient in the intervention group will be compared with each patient in the control group according to this score: a win, loss, or tie will be defined for each pair based on which scored better.
Endpoint(s): In-hospital death (all-cause) at day 28, Occurrence of organ dysfunction: need for extracorporeal membrane oxygenation (ECMO), invasive mechanical ventilation (MV), renal replacement therapy (RRT) and vasopressors, Number of days alive without life support (ECMO, MV, RRT and vasopressor) at day 28, Duration of supplemental oxygen use, non-invasive ventilation, high flow oxygen at day 28, Length of stay in hospital and ICU, Nasopharyngeal viral load measured at subsequent time-points (baseline, day 4, day 8), SF-36 quality of life questionnaire at day 90, 90-day mortality, Safety endpoint: occurrence of adverse events between D0 and D28: a. Hyperglycaemia (i.e., need for new insulin or increase in insulin >30% from initial/baseline dose); b. Clinically significant gastrointestinal bleeding (requiring endoscopy or red blood cell transfusion); c. Occurrence of Influenza-associated pulmonary aspergillosis ; d. Occurrence of ventilatory-acquired pneumonia ; e. New episodes of septic shock according to the Sepsis-3 criteria

Source: https://euclinicaltrials.eu/ctis-public/view/2025-524976-40-00